EU clinical trial 2024-518698-32-00: An adaptive, randomized, double-blind, single-center, placebo-controlled first-in-human study evaluating safety, tolerability and exposure of single and multiple ascending doses of Lactobacillus expressing CXCL12 administered topically to experimentally induced skin wounds
Protocol code: IP-CT-001
Sponsor: Ilya Pharma AB (publ) (Pharmaceutical company). Phase: Human Pharmacology (Phase I)- First administration to humans. Countries: Sweden (authorised, recruitment pending).
Therapeutic area(s): Not possible to specify
Gender: Female, Male. Age: 18-64 years. Enrolment: 36.
Status: Authorised, recruitment pending. Decision date: 2024-11-26. Results received: No. Last updated: 2024-11-26.

Condition(s): Wound healing

Source: https://euclinicaltrials.eu/ctis-public/view/2024-518698-32-00